EU clinical trial 2025-524629-42-00: Omalizumab for monotherapy treatment of patients with food allergies to plant-based foods due to sensitization to LTP and profilin
Protocol code: ID/OMA2025
Sponsor: Fundacion Publica Andaluza Para La Investigacion De Malaga En Biomedicina Y Salud (Laboratory/Research/Testing facility). Phase: Therapeutic exploratory (Phase II). Countries: Spain (authorised, recruitment pending).
Therapeutic area(s): Not possible to specify
Gender: Female, Male. Age: 0-17 years, 18-64 years. Enrolment: 37.
Status: Authorised, recruitment pending. Decision date: 2026-04-17. Results received: No. Last updated: 2026-04-17.

Condition(s): Categoria 2, Patients with vegetable allergies due to sensitization to profilin and LTPs, and those patients in whom sublingual immunotherapy with Pru p 3 (peach LTP) has not been effective, were evaluated in a before-after study to assess changes in clinical reactivity to LTP (peach) and profilin (melon) and immunological changes after intervention with omalizumab.
Product: Omlyclo 75 mg solution for injection in pre-filled syringe

Primary endpoint: Clinical efficacy defined as an increase in the amounts of peach in patients allergic to LTP and melon in patients allergic to apple tolerated in PPO after 16 weeks of treatment with omalizumab.
Endpoint(s): Clinical efficacy defined as an increase in the amounts of at least 1 other food related to sensitisation to LTP (quantitative)., Clinical efficacy defined as an increase in the amounts of at least 1 more food related to sensitisation to profilin (quantitative)., Analysis of quality of life before and after treatment with omalizumab.

Source: https://euclinicaltrials.eu/ctis-public/view/2025-524629-42-00